EU clinical trial 2024-518269-92-00: Effects and health economic aspects of enzyme therapy in children and adults with Pompe disease; Long-term follow-up of patients receiving commercially available Myozyme
Protocol code: Pompe phys 02
Sponsor: Erasmus Universitair Medisch Centrum Rotterdam (Erasmus MC) (Hospital/Clinic/Other health care facility). Phase: Therapeutic use (Phase IV). Countries: Netherlands (authorised, recruitment pending).
Therapeutic area(s): Diseases [C] - Musculoskeletal Diseases [C05]; Diseases [C] - Nutritional and Metabolic Diseases [C18]
Gender: Female, Male. Age: 0-17 years, 18-64 years, 65+ years. Enrolment: 156.
Status: Authorised, recruitment pending. Decision date: 2024-12-16. Results received: No. Last updated: 2024-12-16.

Condition(s): Pompe disease / glycogenosis type II / acid maltase deficiency
Product: Myozyme 50 mg powder for concentrate for solution for infusion

Primary endpoint: Survival, Muscle strength and function, Motor and mental outcome, Pulmonary function, Cardiac hypertrophy and function, Hearing loss, Disease specific symptoms, handicap, quality of life and fatigue, Muscle mass and regeneration, Costs

Source: https://euclinicaltrials.eu/ctis-public/view/2024-518269-92-00